EU clinical trial 2024-510634-41-00: A Phase 2, Multicenter Study to Evaluate the Efficacy and Safety Using Autologous Tumor Infiltrating Lymphocytes (LN-145) in Patients with Recurrent, Metastatic, or Persistent Cervical Carcinoma
Protocol code: C-145-04
Sponsor: Iovance Biotherapeutics Inc. (Pharmaceutical company). Phase: Therapeutic exploratory (Phase II). Countries: Germany (ended), Netherlands (ended), France (ended), Italy (ended), Spain (ended).
Therapeutic area(s): Diseases [C] - Neoplasms [C04]
Gender: Female. Age: 18-64 years, 65+ years. Enrolment: 95.
Status: Ended. Start date (EU): 2018-02-22. End date (EU): 2024-09-21. End date: 2025-08-22. Decision date: 2024-03-20. Results received: Yes. Last updated: 2025-05-09.
Decision dates by country: FR: 2024-03-20, DE: 2024-03-27, IT: 2024-03-25, ES: 2024-03-20, NL: 2024-03-20

Condition(s): Recurrent, metastatic, or persistent Cervical Carcinoma
Product: FLUDARABINE PHOSPHATE, ALDESLEUKIN, LN-145, FLUDARABINE PHOSPHATE, CYCLOPHOSPHAMIDE

Primary endpoint: • Cohort 1 and 2: ORR as assessed by the IRC per RECIST v1.1; • Cohort 3: Incidence of Grade ≥ 3 treatment-emergent adverse events (TEAEs); • Cohorts 4 and 5: Because of the small sample size, results will be reported as appropriate by descriptive statistics.
Endpoint(s): Cohort 1 and 2: DOR, DCR, and PFS as assessed by the IRC per RECIST v1.1., Cohort 1 and 2: ORR, DOR, DCR, and PFS as assessed by the Investigator per RECIST v1.1., Cohort 1 and 2: OS, Cohort 1 and 2: Incidence of severity, seriousness, relationship to study treatment, and characteristics of treatment-emergent adverse events (TEAEs), including serious AEs (SAEs), therapy-related AEs, and AEs leading to early discontinuation from treatment or withdrawal from the Assessment Period or death., Cohort 3: ORR, DOR, DCR, and PFS as assessed by the Investigator per RECIST v1.1., Cohort 3: OS, Cohorts 4 and 5: Because of the small sample size, results will be reported as appropriate by descriptive statistics.

Source: https://euclinicaltrials.eu/ctis-public/view/2024-510634-41-00